EU clinical trial 2024-512295-36-00: I9X-MC-MTAE: Assessment of Safety, Tolerability, and Efficacy of LY3372689 in Early Symptomatic Alzheimer’s Disease
Protocol code: I9X-MC-MTAE
Sponsor: Eli Lilly & Co. (Pharmaceutical company). Phase: Therapeutic exploratory (Phase II). Countries: Poland (ended).
Therapeutic area(s): Diseases [C] - Nervous System Diseases [C10]
Gender: Female, Male. Age: 18-64 years, 65+ years. Enrolment: 55.
Status: Ended. Start date (EU): 2021-12-06. End date (EU): 2025-03-31. End date: 2025-05-22. Decision date: 2024-11-26. Results received: Yes. Last updated: 2024-11-26.

Condition(s): Alzheimer Disease
Product: Flortaucipir, Placebo to match LY3372689

Primary endpoint: Change from Baseline to End Time Point in Integrated Alzheimer's Disease Rating Scale (iADRS)

Source: https://euclinicaltrials.eu/ctis-public/view/2024-512295-36-00